EU clinical trial 2024-513650-30-00: OPTI-TREX - Dose-adjustment of enoxaparin by a bayesian pharmacological approach in pediatric renal transplant recipients
Protocol code: APHP180617
Sponsor: Assistance Publique Hopitaux De Paris (Hospital/Clinic/Other health care facility). Phase: Therapeutic confirmatory (Phase III). Countries: France (ended).
Therapeutic area(s): Not possible to specify
Gender: Female, Male. Age: 0-17 years, 18-64 years. Enrolment: 50.
Status: Ended. Start date (EU): 2023-06-28. End date (EU): 2025-09-01. Decision date: 2024-07-05. Results received: No. Last updated: 2025-05-23.

Condition(s): Allograft vascular thrombosis
Product: ENOXAPARIN

Primary endpoint: Anti-Xa activity within the target range (i.e., success defined by an anti-Xa activity ≥0.3 IU/mL and ≤0.5 IU/mL) 28-30 hours after initiation of treatment.

Source: https://euclinicaltrials.eu/ctis-public/view/2024-513650-30-00